EU clinical trial 2023-507189-17-00: A Phase 2, Open-Label, Multi-Center, Randomized Study of TAR-200 in Combination with Cetrelimab and Cetrelimab Alone in Participants with Muscle-Invasive Urothelial Carcinoma of the Bladder who are Scheduled for Radical Cystectomy and are Ineligible for or Refusing Platinum-Based Neoadjuvant Chemotherapy
Protocol code: 17000139BLC2002
Sponsor: Janssen - Cilag International (Pharmaceutical company). Phase: Therapeutic exploratory (Phase II). Countries: Germany (ended), Netherlands (ended), Spain (ended), Belgium (ended), France (ended), Italy (ended).
Therapeutic area(s): Diseases [C] - Neoplasms [C04]
Gender: Female, Male. Age: 18-64 years, 65+ years. Enrolment: 89.
Status: Ended. Start date (EU): 2022-01-09. End date (EU): 2026-03-26. End date: 2026-03-31. Decision date: 2024-05-03. Results received: No. Last updated: 2026-02-06.
Decision dates by country: NL: 2024-05-03, ES: 2024-05-07, DE: 2024-05-03, BE: 2024-05-17, FR: 2024-05-14, IT: 2024-05-13

Condition(s): Muscle-Invasive Urothelial Carcinoma of the Bladder
Product: JNJ-17000139, JNJ-63723283, JNJ-63723283

Primary endpoint: pCR rate at radical cystectomy (RC)
Endpoint(s): • Frequency and grade of AEs • Laboratory abnormalities • Recurrence-free survival (RFS)

Source: https://euclinicaltrials.eu/ctis-public/view/2023-507189-17-00